EU clinical trial 2024-515783-31-00: Elotuzumab (E) in Combination with Carfilzomib, Lenalidomide and Dexamethasone (E-KRd) versus KRd prior to and following Autologous Stem Cell Transplant in Newly Diagnosed Multiple Myeloma and Subsequent Maintenance with Elotuzumab and Lenalidomide versus Single-Agent Lenalidomide - A phase III study by DSMM (Deutsche Studiengruppe Multiples Myelom)
Protocol code: DSMM_XVII
Sponsor: Universitaetsklinikum Wuerzburg AöR (Hospital/Clinic/Other health care facility). Phase: Therapeutic confirmatory (Phase III). Countries: Germany (ongoing, recruitment ended), Austria (ongoing, recruitment ended).
Therapeutic area(s): Diseases [C] - Neoplasms [C04]
Gender: Female, Male. Age: 18-64 years, 65+ years. Enrolment: 574.
Status: Ongoing, recruitment ended. Start date (EU): 2018-08-24. Decision date: 2024-10-17. Results received: No. Last updated: 2026-04-30.
Decision dates by country: AT: 2024-11-18, DE: 2024-10-17

Condition(s): Newly Diagnosed Multiple Myeloma
Product: Lenalidomide, Empliciti 400 mg powder for concentrate for solution for infusion., LENALIDOMIDE, Elotuzumab, DEXAMETHASONE, Elotuzumab, DEXAMETHASONE DIHYDROGEN PHOSPHATE DISODIUM PH. EUR., Kyprolis 60 mg powder for solution for infusion, LENALIDOMIDE, LENALIDOMIDE, Lenalidomide, Lenalidomide, Lenalidomide

Primary endpoint: For the induction phase: Rate of patients who have VGPR or better response according to IMWG criteria and are MRD-negative as assessed by flow cytometry following six cycles of induction treatment, For the maintenance phase: 3-year PFS rate calculated from randomization
Endpoint(s): 1. Objective response rate (ORR) following induction and consolidation treatment with EKRd versus KRd (response evaluation according to IMWG criteria, refer to Appendix A), 2. ORR at the end of study treatment programme following induction, ASCT, consolidation, and maintenance treatment (response evaluation according to IMWG criteria, refer to Appendix A; target population: Intent - to - Treat), 3. PFS, defined as the time from randomization to the date of disease progression after firstline therapy (study treatment) or death from any cause, 4. PFS 2, defined as the time from randomization to the date of disease progression or death from any cause during/after second-line therapy in the Intent-to-Treat Population, 5. PFS and OS in correlation with cytogenetic abnormalities, 6. Improvement of MRD negativity rate as assessed by flow-cytometry following consolidation treatment, 7. Improvement of MRD negativity rate as assessed by flow-cytometry during maintenance treatment, 8. Disease-free survival (DFS) for patients who obtain MRD negativity as assessed by flowcytometry (at any time point), 9. OS, 10. OS for patients who obtain MRD negativity as assessed by flow-cytometry (at any time point), 11. QoL evaluated with EORTC-QLQ C30 and EORTC multiple myeloma module QLQ-MY20, 12. Type, incidence, relatedness, and severity of adverse events according to NCI CTCAE version 4.03, 13. Occurrence of laboratory abnormalities

Source: https://euclinicaltrials.eu/ctis-public/view/2024-515783-31-00